EU clinical trial 2025-524044-35-00: A Randomized, Non-inferiority Trial Comparing 7-Day Versus 4-Week Esomeprazole Treatment in Patients with Unexplained Dyspepsia
Sponsor: Landspitali (Hospital/Clinic/Other health care facility). Phase: Therapeutic use (Phase IV). Countries: Iceland (authorised, recruitment pending).
Therapeutic area(s): Diseases [C] - Digestive System Diseases [C06]
Gender: Female, Male. Age: 18-64 years. Enrolment: 128.
Status: Authorised, recruitment pending. Decision date: 2026-02-06. Results received: No. Last updated: 2026-02-06.

Condition(s): Dyspepsia
Product: Esomeprazol Krka 40 mg magensaftresistente Hartkapseln, Rennie 680 mg/80 mg tuggutöflur

Primary endpoint: Change in mean daily modified Glasgow Dyspepsia Severity Score (GDSS) from Week 1 (Days 1-7) to Weeks 2-4 (Days 8-28); treatment effect is the between-arm difference in this change (non-inferiority margin 2 points).
Endpoint(s): The arm by time period interaction effect in a linear mixed effects model of the daily modified Glasgow Dyspepsia Score. Time period is a binary variable, the first week vs weeks 5-7.Incidence rate of referrals to upper gastrointestinal endoscopy during study weeks 1 through 7.

Source: https://euclinicaltrials.eu/ctis-public/view/2025-524044-35-00